EU clinical trial 2023-507859-29-00: A prospective, randomized, double-blind, controlled trial on the application of a 10%-lidocain spray prior to the insertion of a peripheral intra-venous catheter in female adults
Protocol code: V 1.0, 23AUG2023
Sponsor: Ordensklinikum Linz GmbH (Hospital/Clinic/Other health care facility). Phase: Therapeutic use (Phase IV). Countries: Austria (ended).
Therapeutic area(s): Analytical, Diagnostic and Therapeutic Techniques and Equipment [E] - Anesthesia and Analgesia [E03]
Gender: Female. Age: 18-64 years. Enrolment: 40.
Status: Ended. Start date (EU): 2024-05-07. End date (EU): 2024-05-22. Decision date: 2024-03-18. Results received: Yes. Last updated: 2024-03-18.

Condition(s): Pain
Product: Physiologische Kochsalzlösung „Fresenius“ - Infusionslösung, Xylocaine 10 mg Spray

Primary endpoint: Pain caused by PIVC rated by NRS separately for the back of the plantar side of the hand/vessel at the dorsum manus, and for the forearm/cubita.
Endpoint(s): Pain caused by PIVC rated by NRS separately for the back of the plantar side of the hand/vessel at the dorsum manus, and for the forearm/cubita., Pain caused by PIVC at the plantar side of the hand/vessel at the dorsum manus, vs. at the forearm/cubita, Correlation between pain caused by PIVC and the anticipated pain, Correlation between pain caused by PIVC and the anticipated difficulty by the operator to insert the PIVC, Success rate of the venepuncture by descriptive analysis and comparison, Pain caused by PIVC broken down by success/failure of insertion of PIVC, Correlation between pain caused by PIVC and PCS

Source: https://euclinicaltrials.eu/ctis-public/view/2023-507859-29-00